EU clinical trial 2024-514016-26-00: An open label, multicenter, Phase 2, pilot study, evaluating early treatment with bispecific T-cell redirectors (teclistamab and talquetamab) in the frontline therapy of newly diagnosed high-risk multiple myeloma
Protocol code: GEM-TECTAL
Sponsor: Fundacion Pethema (Patient organisation/association). Phase: Therapeutic exploratory (Phase II). Countries: Spain (ongoing, recruitment ended).
Therapeutic area(s): Diseases [C] - Hemic and Lymphatic Diseases [C15]
Gender: Female, Male. Age: 18-64 years, 65+ years. Enrolment: 30.
Status: Ongoing, recruitment ended. Start date (EU): 2023-06-22. Decision date: 2024-08-02. Results received: No. Last updated: 2025-05-07.

Condition(s): Multiple Myeloma
Product: LENALIDOMIDE, DEXAMETHASONE, LENALIDOMIDE, DARZALEX 1800 mg solution for injection, TECVAYLI 10 mg/mL solution for injection, LENALIDOMIDE, TALVEY 2 mg/mL solution for injection, TALVEY 40 mg/mL solution for injection, LENALIDOMIDE, LENALIDOMIDE, TECVAYLI 90 mg/mL solution for injection, VELCADE 3.5 mg powder for solution for injection

Primary endpoint: MRD measured by NGF (sensitivity level of 10-6) and FDG PET-CT scan using the Deauville score and CR evaluated per IMWG 2016 response criteria after 6 cycles of Tec-Dara therapy
Endpoint(s): MRD measured by NGF (sensitivity level of 10-6) and FDG PET-CT scan using the Deauville score and CR evaluated per IMWG 2016 response criteria after 4 cycles of D-VRD induction, MRD negative rates measured by NGS, and QIP-MS-FLC after 6 cycles of Tec-Dara therapy, Percentage of patients converting from positive MRD to negative MRD evaluated by NGF, NGS, QIP-MS-FLC and FDG-PET-CT scan., Percentage of patients converting from positive MRD after D-VRD induction to negative MRD evaluated by NGF, NGS, QIP-MS-FLC and FDG-PET-CT scan after Tec-Dara intensification., Proportion of patients with persistent MRD negative disease at month 6, 12, 18 and 24 of maintenance treatment in both Tec-Dara and Tal-Dara treatment, by NGF, NGS, QIP-MS-FLC and FDG-PET-CT scan and annually thereafter, Proportion of patients relapsing from MRD negative CR to MRD positive or who relapse from CR (not fulfilling criteria for disease progression) during any phase of Tec-Dara treatment (intensification or maintenance), PFS, EFS, TNT, DoR and OS, Incidence of treatment-emergent adverse events, Analysis of immune subpopulation and genetic markers.

Source: https://euclinicaltrials.eu/ctis-public/view/2024-514016-26-00